EU clinical trial 2023-505040-19-00: A prospective program aiming at improving outcome for young adults with poor-prognosis non seminomatous germ-cell tumors (VAPOR (GETUG T06))
Protocol code: 2021/3282
Sponsor: Institut Gustave Roussy (Hospital/Clinic/Other health care facility). Phase: Therapeutic exploratory (Phase II). Countries: France (ongoing, recruiting).
Therapeutic area(s): Diseases [C] - Neoplasms [C04]; Diseases [C] - Male Urogenital Diseases [C12]
Gender: Male. Age: 0-17 years, 18-64 years. Enrolment: 150.
Status: Ongoing, recruiting. Start date (EU): 2023-04-11. Decision date: 2023-08-04. Results received: No. Last updated: 2026-02-17.

Condition(s): Non-seminomatous germ-cell tumors (including testis, retroperitoneal and mediastinal primaries) with a disseminated disease (clinical stages II or III according to AJCC 8th edition) and classified as poor prognosis according to IGCCCG criteria.
Product: PACLITAXEL SANDOZ 6 mg/ml, solution à diluer pour perfusion, MESNA EG 100 mg/ml, solution injectable pour perfusion, CISPLATINE KABI 1 mg/ml, solution à diluer pour perfusion, GRANOCYTE 34 Millions UI/ml, poudre et solvant pour solution injectable / perfusion, CARBOPLATINE KABI 10 mg/ml, solution à diluer pour perfusion, ETOPOSIDE ACCORD 20 mg/mL, solution à diluer pour perfusion, BLEOMYCINE BELLON 15 MG, POUDRE POUR SOLUTION INJECTABLE, HOLOXAN 1000 mg, poudre pour solution injectable, GRANOCYTE 13 Millions UI/ml, poudre et solvant pour solution injectable / perfusion, OXALIPLATINE ACCORD 5 mg/ml, solution à diluer pour perfusion

Primary endpoint: The primary evaluation criterion of the study is progression-free survival (PFS). PFS will be determined from the first day of the first cycle of BEP to the date of progression or death due to any cause, whichever occurs first. Progression will be defined as: - an increase in tumor markers (...), or - a radiographic progression (...)
Endpoint(s): Efficacy: - Response criteria Best tumor response will be assessed at the end of treatment (after chemotherapy or after surgery of residual masses, if any) (...); - Overall survival (OS) (...), Tolerance: Toxicity: All toxicities will be evaluated and recorded based on the NCI common toxicity criteria (CTCAE v5.0). They will be described by frequency and grade, by cycle and over all cycles, with the maximum grade over all cycles used as the summary measure for each patient. (...) Treatment-related mortality: (...), Quality of life – Patient-related outcomes: The following questionnaires will be used: QLQ-C30, QLQ-TC26, FACT-GOG-NTX and IPQ, Specific endpoints for the diagnostic study assessing the addition of an early systematic brain MRI: - The proportion of initially brain metastases-free patients who are diagnosed with brain metastases early on a systematic brain MRI performed at the middle of the therapeutic strategy. This proportion will be calculated with its exact 95% confidence interval (...) - The survival after brain metastases relapse

Source: https://euclinicaltrials.eu/ctis-public/view/2023-505040-19-00